EU clinical trial 2024-516718-39-00: Nivolumab dose optimization in patients with a complete, partial or stable response (NIVOPTIMIZE-trial)
Sponsor: Erasmus Universitair Medisch Centrum Rotterdam (Erasmus MC) (Hospital/Clinic/Other health care facility). Phase: Therapeutic use (Phase IV). Countries: Netherlands (authorised, recruitment pending).
Therapeutic area(s): Diseases [C] - Neoplasms [C04]
Gender: Female, Male. Age: 18-64 years, 65+ years. Enrolment: 34.
Status: Authorised, recruitment pending. Decision date: 2024-08-15. Results received: No. Last updated: 2024-08-15.

Condition(s): Melanoma, Renal cell carcinoma
Product: NIVOLUMAB

Primary endpoint: Difference between the mean trough level 4 weeks after the 3rd nivolumab dose of 240 mg and the mean trough level 4 weeks after treatment start (i.e. 4 weeks after the first 6 mg/kg or 480 mg dose)
Endpoint(s): PD-1 receptor occupancy in PBMCs, measured 4 weeks after 3 reduced nivolumab doses, Grade ≥3 adverse events during reduced doses, Number of patients with new PD during 3 reduced doses, Pharmacokinetic profile of nivolumab, Cost effectiveness

Source: https://euclinicaltrials.eu/ctis-public/view/2024-516718-39-00